EU clinical trial 2023-510560-12-00: Phase II Open-Label, Single Arm, Multicenter Study of Ciltacabtagene Autoleucel in High-Risk Smoldering Multiple Myeloma (GEM-CAR-HiRiSMM)
Protocol code: GEM-CAR-HiRiSMM
Sponsor: Fundacion Pethema (Patient organisation/association). Phase: Therapeutic exploratory (Phase II). Countries: Spain (ongoing, recruiting).
Therapeutic area(s): Diseases [C] - Neoplasms [C04]
Gender: Female, Male. Age: 18-64 years, 65+ years. Enrolment: 20.
Status: Ongoing, recruiting. Start date (EU): 2026-07-23. Decision date: 2024-08-16. Results received: No. Last updated: 2026-07-23.

Condition(s): High-risk smoldering multiple myeloma
Product: FLUDARABINE, DEXAMETHASONE, CARVYKTI 3.2 × 10^6 – 1 × 10^8 cells dispersion for infusion, DARATUMUMAB, BORTEZOMIB, CYCLOPHOSPHAMIDE, LENALIDOMIDE

Primary endpoint: To evaluate the proportion of high risk SMM patients with undetectable MRD at 6 months (defined as an MRD-negative at 6m), 12 months (defined as an MRD-negative at 12m), and thereafter every 12m up to 5y after cilta-cel administration as well as the sustained undetectable MRD rate (defined as MRD-negative for at a minimum 12 months duration) in the ITT population. MRD will be evaluated in the bone marrow by Next-Generation Flow and N-G Sequencing with sensitivity level of 10‐5 and 10-6., Nature, frequency, severity, and timing of adverse events (AEs), discontinuations due to AEs, and serious adverse events (SAEs)., Selected safety laboratory tests: IgG levels, CBC cytopenia, CD4/CD8 lymphocyte panel and CAR-T chemistry.
Endpoint(s): To evaluate the proportion of high risk SMM patients who achieve a PR or better according to IMWG criteria, To evaluate the proportion of high risk SMM patients who achieve PR, VGPR, CR, and sCR according to IMWG criteria, To evaluate the duration of response in patients who achieve PR or better according to IMWG criteria, To assess PFS until progression to myeloma (with myeloma-defining events)., To assess PFS to biochemical progression, To assess PFS2, To assess time to progression (IMWG criteria; Appendix 9) from the date of the first administration of study treatment, To assess overall survival from the date of the initial infusion of cilta-cel to the date of the participant's death, To evaluate mass spectrometry quantification of M-protein to be correlated with the conventional responses as well as MRD testing, Immune profiling at baseline and sequentially after cilta-cel administration, sequentially (in peripheral blood and bone marrow) and by 12-color multidimensional flow cytometry and single cell RNA (scRNA) seq, Cellular characterization of apheresis product and manufacturing samples from Group 1 and Group 2 by using genomic sequencing, proteomics and/or flow cytometry approaches, Proportion of high-risk SMM patients who achieved undetectable MRD and sustained undetectable MRD by using Next-Generation Flow and Next-Generation Sequencing with sensitivity level of 10‐6

Source: https://euclinicaltrials.eu/ctis-public/view/2023-510560-12-00